EU clinical trial 2023-510015-19-00: A Phase III, Randomized, Open-Label, Multi-Center, Global Study to Determine the Efficacy and Safety of Durvalumab in Combination with Gemcitabine+Cisplatin for Neoadjuvant Treatment Followed by Durvalumab Alone for Adjuvant Treatment in Patients with Muscle-Invasive Bladder Cancer
Sponsor: AstraZeneca AB (Pharmaceutical company). Phase: Therapeutic confirmatory (Phase III). Countries: Poland (ongoing, recruitment ended), Germany (ongoing, recruitment ended), France (ongoing, recruitment ended), Italy (ongoing, recruitment ended), Czechia (ongoing, recruitment ended), Belgium (ongoing, recruitment ended), Spain (ongoing, recruitment ended), Netherlands (ongoing, recruitment ended).
Therapeutic area(s): Diseases [C] - Neoplasms [C04]
Gender: Female, Male. Age: 18-64 years, 65+ years. Enrolment: 403.
Status: Ongoing, recruitment ended. Start date (EU): 2019-02-11. Decision date: 2024-02-26. Results received: No. Last updated: 2026-07-29.
Decision dates by country: ES: 2024-02-27, BE: 2024-02-26, IT: 2024-02-26, NL: 2024-06-14, PL: 2024-02-29, DE: 2024-02-26, CZ: 2024-06-12, FR: 2024-02-28

Condition(s): Patients with histologically or cytologically documented muscle-invasive transitional cell carcinoma (TCC) of the bladder
Product: GEMCITABINE, INFLIXIMAB, MYCOPHENOLATE MOFETIL, CISPLATIN, DURVALUMAB, GEMCITABINE

Primary endpoint: pCR;EFS
Endpoint(s): EFS, pCR, EFS24 Proportion of patients who achieve

Source: https://euclinicaltrials.eu/ctis-public/view/2023-510015-19-00